EU clinical trial 2024-512097-98-00: An open-label dose escalation study to evaluate safety, tolerability, biodistribution and efficacy of [90Y]Y-PentixaTher for the therapy of recurrent or refractory primary or isolated secondary central nervous system lymphoma
Protocol code: PTT101
Sponsor: Pentixapharm AG (Pharmaceutical company). Phase: Phase I and Phase II (Integrated)- Other. Countries: Germany (ongoing, recruiting).
Therapeutic area(s): Diseases [C] - Neoplasms [C04]
Gender: Female, Male. Age: 18-64 years, 65+ years. Enrolment: 15.
Status: Ongoing, recruiting. Start date (EU): 2023-11-07. Decision date: 2024-04-10. Results received: No. Last updated: 2026-07-08.

Condition(s): Central nervous system (CNS) lymphoma; recurrent or refractory primary or isolated secondary
Product: [68Ga]Ga-PentixaFor, LysaKare 25 g/25 g solution for infusion, [90Y]Y-PentixaTher

Primary endpoint: Incidence, severity and relationship of (S)AEs (graded in severity according to NCI CTCAE version 5.0), Incidence and severity of DLT, Changes from baseline in vital signs., Changes from baseline in laboratory parameters (hematology and biochemistry, urinalysis)., Abnormal findings in physical examination, Findings 12-lead ECG, SCT after treatment, Mortality rate at 30 and 90 days post-treatment
Endpoint(s): Biodistribution: • Maximal uptake (%) for tumor lesion • Maximal uptake (%) in discernible organs • TAC in discernible thoracic and abdominal organs, target lesion and blood • AUC of 90Y-PTT in discernible thoracic and abdominal organs, target lesion and blood • AUC of 90Y-PTT in urine, Radiation dosimetry: • Organ receiving the highest absorbed dose • Specific absorbed dose per organ and for target lesion • Cumulative absorbed organ/lesion doses, Efficacy • ORR at one month and three months • PFS at one month and three months • Rate of CR and PR at one month and three months • PFS at 12 month • OS at one month, 3 months, 12 months

Source: https://euclinicaltrials.eu/ctis-public/view/2024-512097-98-00